EU clinical trial 2025-522431-34-00: TAILOR-PANC: Molecularly Tailored Therapy versus Standard Care in Advanced Pancreatic Cancer (DPCG-02)
Protocol code: PA 2506
Sponsor: Region Hovedstaden (Hospital/Clinic/Other health care facility). Phase: Therapeutic exploratory (Phase II). Countries: Denmark (authorised, recruitment pending).
Therapeutic area(s): Diseases [C] - Neoplasms [C04]
Gender: Female, Male. Age: 18-64 years, 65+ years. Enrolment: 1200.
Status: Authorised, recruitment pending. Decision date: 2026-05-18. Results received: No. Last updated: 2026-05-18.

Condition(s): Advanced pancreatic cancer
Product: OLAPARIB, ERLOTINIB, CRIZOTINIB, OXALIPLATIN, TRAMETINIB, OLAPARIB, PEMIGATINIB, SELPERCATINIB, AXITINIB, SELPERCATINIB, PEMIGATINIB, VISMODEGIB, CRIZOTINIB, ERLOTINIB, CAPECITABINE, PEMBROLIZUMAB, IRINOTECAN, LAROTRECTINIB, ERLOTINIB, DABRAFENIB, CAPECITABINE, PEMIGATINIB, AXITINIB, FLUOROURACIL, LAROTRECTINIB, AXITINIB, DABRAFENIB, Phesgo 1200 mg/600 mg solution for injection, TRAMETINIB, CALCIUM FOLINATE, Phesgo 600 mg/600 mg solution for injection, GEMCITABINE, PACLITAXEL ALBUMIN-BOUND, AXITINIB

Primary endpoint: Progression-free survival
Endpoint(s): Overall Survival (OS) and OS rate at 6 and 12 months, Objective Response Rate and Disease Control Rate, Duration of Response, Progression-free survival on subsequent treatment (PFS 2), Adverse events with causal relationship to study treatment, Adjusted mean change from baseline in global health status/QoL score, and functional and symptom scales from the EORTC QLQ-C30 questionnaire.

Source: https://euclinicaltrials.eu/ctis-public/view/2025-522431-34-00